EU clinical trial 2023-508229-28-00: High-Intensity Inpatient MDMA-Assisted Psychotherapy for Treatment-Refractory Posttraumatic Stress Disorder: An Open-Label Pilot Study
Sponsor: Arq National Psychotrauma Centre (Patient organisation/association). Phase: Therapeutic exploratory (Phase II). Countries: Netherlands (ongoing, recruiting).
Therapeutic area(s): Psychiatry and Psychology [F] - Mental Disorders [F03]
Gender: Female, Male. Age: 18-64 years. Enrolment: 20.
Status: Ongoing, recruiting. Start date (EU): 2025-05-16. Decision date: 2024-04-18. Results received: No. Last updated: 2026-06-08.

Condition(s): posttraumatic stress disorder
Product: 3,4-methylenedioxymethamphetamine hydrochloride, 3,4-methylenedioxymethamphetamine hydrochloride

Primary endpoint: Mean change in CAPS-5-R Total Severity Score from Baseline (Visit 4) to 12 weeks post Baseline (Visit 23).
Endpoint(s): Mean change in Sheehan Disability Scale (SDS) scores from Visit 4 (Baseline) to Visit 23 (12 weeks post Baseline)., Number, percentage and reasons for Screen Failure and Dropout.

Source: https://euclinicaltrials.eu/ctis-public/view/2023-508229-28-00